EU clinical trial 2023-506395-27-00: DETOUR; Determining the safety and feasibility of optical coherence tomography and near infrared fluorescence: a prospective pilot intervention study
Sponsor: Universitair Medisch Centrum Groningen (Hospital/Clinic/Other health care facility). Phase: Phase I and Phase II (Integrated)- Other. Countries: Netherlands (ongoing, recruiting).
Therapeutic area(s): Diseases [C] - Neoplasms [C04]; Diseases [C] - Digestive System Diseases [C06]
Gender: Female, Male. Age: 18-64 years, 65+ years. Enrolment: 15.
Status: Ongoing, recruiting. Start date (EU): 2024-03-15. Decision date: 2024-01-22. Results received: No. Last updated: 2024-10-03.

Condition(s): Barrett's esophagus, Colon carcinoma, gastrointestinal dysplasia
Product: Avastin 25 mg/ml concentrate for solution for infusion.

Primary endpoint: Safety evaluation of immuno-OCT imaging: Number of adverse device-related events (ADE’s) and serious adverse device-related events (SADE’s)., Feasibility of in vivo immuno-OCT imaging and interpretation of the in vivo immuno-OCT results
Endpoint(s): Validation of the immuno-OCT endoscopy results compared to: Fluorescence seen in FME imaging results; The correlation of ex vivo fluorescent signals to histopathological analysis results; The correlation of in vivo and ex vivo immuno-OCT imaging to histopathological analysis results;

Source: https://euclinicaltrials.eu/ctis-public/view/2023-506395-27-00